EU clinical trial 2024-517602-28-00: The effect of corticosteroids on early recovery after major surgery in eldery patients: CORTERAS study
Sponsor: Ziekenhuis Oost Limburg (Hospital/Clinic/Other health care facility). Phase: Therapeutic use (Phase IV). Countries: Belgium (authorised, recruitment pending).
Therapeutic area(s): Analytical, Diagnostic and Therapeutic Techniques and Equipment [E] - Anesthesia and Analgesia [E03]
Gender: Female, Male. Age: 18-64 years, 65+ years. Enrolment: 674.
Status: Authorised, recruitment pending. Decision date: 2024-10-22. Results received: No. Last updated: 2024-10-22.

Condition(s): Major surgery: robotic assisted laparoscopic radical prostatectomies, Major surgery: peripheral vascular surgery (femoral popliteal bypass, tibial bypass, profundaplasty), Major surgery: on pump coronary bypass surgery, Major surgery: off pump coronary bypass surgery, Major surgery: thoracoscopic lung resection surgery, Major surgery: laparoscopic colorectal surgery, Major surgery: minimal invasive valve repair or replacement surgery
Product: Solu-Medrol S.A.B. (= Sine Alcohol Benzylicus) 125 mg Poeder en oplosmiddel voor oplossing voor injectie (methylprednisolon), Sodium Chloride 0.9% Intravenous Infusion

Primary endpoint: Postoperative muscle strength
Endpoint(s): Postoperative muscle function, Postoperative lung function, Cognitive status (S5Q), Fatigue questionnaire (Chalder fatigue questionnaire), QoR-15 questionnaire, EQ5D, NRS pain score 0-10, PONV, Biochemical analyses and markers of coagulation

Source: https://euclinicaltrials.eu/ctis-public/view/2024-517602-28-00